EU clinical trial 2023-506976-28-00: A Phase 1/2, Open-Label, Multicenter Trial Investigating the Safety, Tolerability, and Preliminary Antineoplastic Activity of IPH6501 in Patients with Relapsed and/or Refractory CD20-expressing Non-Hodgkin Lymphoma
Protocol code: IPH6501-101
Sponsor: Innate Pharma (Pharmaceutical company). Phase: Phase I and Phase II (Integrated)- Other. Countries: France (ended).
Therapeutic area(s): Diseases [C] - Neoplasms [C04]
Gender: Female, Male. Age: 18-64 years. Enrolment: 25.
Status: Ended. Start date (EU): 2024-05-16. End date (EU): 2026-01-30. End date: 2026-01-31. Decision date: 2024-03-25. Results received: No. Last updated: 2026-07-23.

Condition(s): Relapsed and/or Refractory CD20-expressing Non-Hodgkin Lymphoma
Product: IPH6501

Primary endpoint: MTD or highest tested dose evaluation, Safety and tolerability analysis
Endpoint(s): Efficacy analysis, Pharmacokinetics and Immunogenicity analysis

Source: https://euclinicaltrials.eu/ctis-public/view/2023-506976-28-00